EU clinical trial 2024-516888-84-00: A study of the safety, absorption and effects of investigational drug ARV-102 in patients with Parkinson's disease.
Protocol code: ARV-102-103
Sponsor: Arvinas Operations Inc. (Pharmaceutical company). Phase: Human Pharmacology (Phase I)- Other. Countries: Netherlands (ended).
Therapeutic area(s): Phenomena and Processes [G] - Musculoskeletal and Neural Physiological Phenomena [G11]
Gender: Female, Male. Age: 18-64 years, 65+ years. Enrolment: 44.
Status: Ended. Start date (EU): 2024-11-12. End date (EU): 2025-12-23. Decision date: 2024-10-29. Results received: No. Last updated: 2025-07-18.

Condition(s): Parkinson's disease.

Source: https://euclinicaltrials.eu/ctis-public/view/2024-516888-84-00